EU clinical trial 2025-522040-40-01: An autologous and antigen-specific cell-based therapy of vitamin D3-treated and myelin-derived peptide loaded tolerogenic dendritic cells in subjects with progressive forms of multiple sclerosis: a phase IIa, open-label, self-controlled, multi-center clinical trial.
Sponsor: Universitair Ziekenhuis Antwerpen, Hospital Germans Trias I Pujol (Hospital/Clinic/Other health care facility). Phase: Therapeutic exploratory (Phase II). Countries: Belgium (authorised, recruitment pending), Spain (authorised, recruitment pending).
Therapeutic area(s): Diseases [C] - Immune System Diseases [C20]
Gender: Female, Male. Age: 18-64 years. Enrolment: 14.
Status: Authorised, recruitment pending. Decision date: 2026-04-20. Results received: No. Last updated: 2026-04-24.
Decision dates by country: BE: 2026-04-20, ES: 2026-04-24

Condition(s): Multiple Sclerosis
Product: tolDC

Primary endpoint: Evaluate the efficacy of tolDC administration by assessing the change in Expanded Disability Severity Scale (EDSS) score., To assess the safety the tolerability of tolDC administration will be assessed by recording the incidence, severity, and relationship to study treatment of adverse events throughout the trial.
Endpoint(s): Neurological examinations will be complemented with two validated functional tests: the 9-HPT for arm dexterity and the SDMT for cognitive performance. The impact on disability progression will be analyzed by the proportion of participants free from confirmed disability progression, Various MRI measures will be followed for safety and efficacy via the number of new and/or enlarging T2 lesions, total brain volume and brain atrophy., Change in Neurofilament Light Chain (NfL) serum and Glial Fibirallary Acidic Protein (GFAP) serum will be assessed as biomarkers, Tertiary end point: To comprehensively assess therapy-related immunological changes and the induction of antigen-specific tolerance, we will perform high-dimensional immune profiling using cryopreserved peripheral blood mononuclear cells (PBMCs) and matched serum/plasma samples collected at predefined time points throughout the trial., Tertiary end point: Participants will report their pain experience using a VAS. Quality of life will be measured using the EQ-5D-5L questionnaire.

Source: https://euclinicaltrials.eu/ctis-public/view/2025-522040-40-01